EU clinical trial 2024-516780-93-00: Prevention of secondary infections by interferon gamma in ICU-acquired sustained immune-suppression: a randomized trial
Protocol code: 87RI24_0040
Sponsor: Centre Hospitalier Et Universitaire De Limoges (Hospital/Clinic/Other health care facility). Phase: Therapeutic confirmatory (Phase III). Countries: France (ongoing, recruiting).
Therapeutic area(s): Diseases [C] - Immune System Diseases [C20]
Gender: Female, Male. Age: 18-64 years, 65+ years. Enrolment: 326.
Status: Ongoing, recruiting. Start date (EU): 2025-07-09. Decision date: 2025-04-22. Results received: No. Last updated: 2026-06-15.

Condition(s): Sustained immunosuppression
Product: CHLORURE DE SODIUM 0,9 % LAVOISIER, solution pour perfusion, IMUKIN 2 X 106 UI (0,1 mg), solution injectable

Primary endpoint: Incidence of secondary infection episodes at three months (Day 90) validated by an independent adjudication committee based on the current standardized definitions (CDC surveillance definitions, January 2024)
Endpoint(s): All-cause ICU mortality and at Day 90, Length of stay in the ICU and in the hospital at Day 90, Antibiotic and antifungal consumption at Day 90, Percentage of biological immune restoration (defined as an HLA-DR > 13 500 Ab/c [Antibodies bound per cell] and an absolute lymphocyte count > 1200 mm3) at Day 10, Healthcare costs at Day 90, cost per secondary infection avoided and cost per additional survivor, isolation requirement and antibiotic resistance, Rate of serious adverse reactions and suspected unexpected serious adverse reaction (SUSAR) at D90

Source: https://euclinicaltrials.eu/ctis-public/view/2024-516780-93-00